EU clinical trial 2024-519628-25-00: English title: Complete remission study Subtitle: Discontinuation of Mepolizumab or Dupilumab after at least 12 months without symptoms in patients with severe Chronic rhinosinusitis with polyps – a National Danish RCT study.
Sponsor: Rigshospitalet (Hospital/Clinic/Other health care facility). Phase: Therapeutic use (Phase IV). Countries: Denmark (ongoing, recruitment ended).
Therapeutic area(s): Diseases [C] - Otorhinolaryngologic Diseases [C09]
Gender: Female, Male. Age: 18-64 years, 65+ years. Enrolment: 66.
Status: Ongoing, recruitment ended. Start date (EU): 2025-04-03. Decision date: 2025-02-09. Results received: No. Last updated: 2025-11-13.

Condition(s): Chronic rrhinosinusitis with nasal polyps
Product: Dupixent 300 mg solution for injection in pre-filled syringe, Nucala 100 mg powder for solution for injection

Primary endpoint: What percentage of patients can stop the biologic treatment and still be in complete remission
Endpoint(s): Is there any differences in what drug the patients have been treated with

Source: https://euclinicaltrials.eu/ctis-public/view/2024-519628-25-00